EU clinical trial 2025-522434-32-00: A MULTICENTER, RANDOMIZED, OPEN-LABEL, PHASE III CLINICAL TRIAL TO EVALUATE THE EFFICACY, SAFETY, PHARMACOKINETICS AND PHARMACODYNAMICS OF NXT007 PROPHYLAXIS VERSUS FACTOR VIII PROPHYLAXIS IN PEOPLE WITH HEMOPHILIA A WITHOUT INHIBITORS
Protocol code: WO45886
Sponsor: F. Hoffmann-La Roche AG (Pharmaceutical company). Phase: Therapeutic confirmatory (Phase III). Countries: France (authorised, recruitment pending), Austria (authorised, recruitment pending), Poland (authorised, recruitment pending), Netherlands (authorised, recruiting), Spain (ongoing, recruiting), Denmark (authorised, recruiting), Italy (authorised, recruiting), Germany (authorised, recruiting), Hungary (ongoing, recruiting).
Therapeutic area(s): Diseases [C] - Hemic and Lymphatic Diseases [C15]; Diseases [C] - Congenital, Hereditary, and Neonatal Diseases and Abnormalities [C16]
Gender: Female, Male. Age: 0-17 years, 18-64 years, 65+ years. Enrolment: 42.
Start date (EU): 2026-07-01. Decision date: 2026-06-01. Results received: No. Last updated: 2026-06-22.
Decision dates by country: FR: 2026-06-05, DE: 2026-06-04, HU: 2026-06-04, IT: 2026-06-04, ES: 2026-06-08, NL: 2026-06-05, PL: 2026-06-05, AT: 2026-06-01, DK: 2026-06-02

Condition(s): Hemophilia A Without Inhibitors
Product: NXT007, NXT007, NXT007, NXT007, COAGULATION FACTOR VIII

Primary endpoint: The annualized number of treated bleeds (ABR) over the main 6-month study treatment period
Endpoint(s): Annualized number of bleeds (ABR) over the main 6-month study treatment period for All bleeds (treated and untreated), Annualized number of bleeds (ABR) over the main 6-month study treatment period for treated spontaneous bleeds, Annualized number of bleeds (ABR) over the main 6-month study treatment period for treated joint bleeds, Quality of Life domain score in adult version at Month 7 visit, Annualized number of treated target joint bleeds (ABR) over the main 6-month study treatment period, Proportion of participants with zero treated bleeds over the main 6-month study treatment period, Number of injections and dose (per body weight) per bleed of coagulation factors administered to treat a bleed over the main 6-month study treatment period, Annualized FVIII injection rate and annualized FVIII consumption excluding regular FVIII prophylaxis and/or prior to procedures or surgeries in each arm over the main 6-month study treatment period, Quality of life domain score in adolescent version at Month 7 visit, Change from baseline in preoccupation, social activity impact and recreational activity impact domain scores, Physical impact domain score at specified timepoints, Incidence and severity of adverse events, with severity determined according to the National Cancer Institute Common Terminology Criteria for Adverse Events version 5.0 (NCI CTCAE v.5.0), Incidence and severity of thromboembolic events and thrombotic microangiopathy, Incidence and severity of injection-site reactions, Incidence of adverse events leading to drug discontinuation, Incidence of severe hypersensitivity, anaphylaxis, or anaphylactoid reactions, Plasma concentration of NXT007 at specified timepoints, Prevalence of anti-NXT007 antibodies (ADA) at baseline and incidence of ADAs during the study, Incidence of neutralizing ADAs

Source: https://euclinicaltrials.eu/ctis-public/view/2025-522434-32-00